EU clinical trial 2023-508922-83-00: A Phase 2 Trial of Adagrasib Monotherapy and in Combination with Pembrolizumab and a Phase 3 Trial of Adagrasib in Combination with Pembrolizumab versus Pembrolizumab in Patients with Advanced Non Small Cell Lung Cancer with KRAS G12C Mutation
Protocol code: 849-007
Sponsor: Mirati Therapeutics Inc. (Pharmaceutical company). Phase: Phase II and Phase III (Integrated). Countries: Portugal (ongoing, recruiting), Germany (ongoing, recruiting), Bulgaria (ongoing, recruiting), Ireland (ongoing, recruiting), Poland (ongoing, recruiting), Italy (ongoing, recruiting), Czechia (ongoing, recruiting), Hungary (ongoing, recruiting), Netherlands (ongoing, recruiting), Austria (ongoing, recruiting), Belgium (ongoing, recruiting), Spain (ongoing, recruiting), Croatia (authorised, recruiting), Denmark (ongoing, recruiting), Finland (authorised, recruiting), France (ongoing, recruiting), Greece (ongoing, recruiting), Romania (ongoing, recruiting), Norway (ended).
Therapeutic area(s): Diseases [C] - Respiratory Tract Diseases [C08]
Gender: Female, Male. Age: 18-64 years, 65+ years. Enrolment: 402.
Start date (EU): 2021-03-17. Decision date: 2024-10-03. Results received: No. Last updated: 2026-08-05.
Decision dates by country: NO: 2025-07-31, FR: 2025-08-08, BE: 2024-10-16, HR: 2025-08-06, GR: 2025-08-04, NL: 2024-10-16, BG: 2024-10-07, CZ: 2024-10-16, FI: 2025-08-04, DK: 2025-08-11, IE: 2024-10-03, PL: 2024-10-13, RO: 2025-08-11, PT: 2024-10-03, AT: 2024-10-16, DE: 2024-10-07, IT: 2024-10-08, HU: 2024-10-16, ES: 2024-10-16

Condition(s): Advanced Non-Small Cell Lung Cancer
Product: KEYTRUDA 25 mg/mL concentrate for solution for infusion, Adagrasib

Primary endpoint: Phase 2: Obejective Response Rate (ORR) as defined by Response Evaluation Criteria in Solid Tumors version 1.1 (RECIST 1.1) by Investigator, Phase 3: Dual primary endpoints: 1. PFS (RECIST 1.1) by BICR 2. OS
Endpoint(s): Phase 2: 1. Safety characterized by type, incidence, severity, timing, seriousness and relationship to study treatment of adverse events and laboratory abnormalities, Phase 2: 2. Duration of Response (DOR), Progression - Free Survival (PFS), 1-Year Survival rate, Overall Survival (OS), Phase 2: 3. Pharmacokinetics (PK) Blood plasma adagrasib and potential metabolite concentrations, Phase 3: 1. PFS (RECIST v1.1) by Investigator - OR (RECIST v1.1) by Investigator and BICR - DOR (RECIST v1.1) by Investigator and BICR1, Phase 3: 2. Safety characterized by type, incidence, severity, timing, seriousness and relationship to study treatment of AEs, laboratory abnormalities, and number of patients discontinuing study treatment due to an AE, Phase 3: 4. Patient-reported outcome (PRO) to measure quality of life

Source: https://euclinicaltrials.eu/ctis-public/view/2023-508922-83-00